EU clinical trial 2024-518263-35-00: An Investigator-Initiated, Phase II, Multicenter, Open-Label, Single-Arm, Prospective Clinical Trial to Evaluate the Efficacy and Safety of Alternating Bortezomib-Based Regimens in Combination with DaratUMumab followed by Maintenance with Daratumumab in the Frontline Setting of Primary Plasma CEll LEukemIA: A Trial of the Greek Myeloma Study Group. The “EUMELEIA” Study
Protocol code: 54767414LEU2002
Sponsor: Hellenic Society Of Hematology (Patient organisation/association). Phase: Therapeutic exploratory (Phase II). Countries: Greece (ongoing, recruiting).
Therapeutic area(s): Diseases [C] - Hemic and Lymphatic Diseases [C15]
Gender: Female, Male. Age: 18-64 years, 65+ years. Enrolment: 43.
Status: Ongoing, recruiting. Start date (EU): 2021-11-23. Decision date: 2024-12-09. Results received: No. Last updated: 2026-06-23.

Condition(s): Primary plasma cell leukemia
Product: DARZALEX 1800 mg solution for injection, VELCADE 3.5 mg powder for solution for injection, DOXORUBICIN HYDROCHLORIDE, DEXAMETHASONE SODIUM PHOSPHATE, DOXORUBICIN HYDROCHLORIDE, CYCLOPHOSPHAMIDE

Primary endpoint: PFS: Duration from the date of induction treatment initiation to the date of first documented evidence of progressive disease (PD) (assessed by the IMWG criteria or death, whichever occurs earlier.
Endpoint(s): Proportions of patients achieving PR or better, VGPR or better, and sCR or CR (as determined by the IMWG criteria)

Source: https://euclinicaltrials.eu/ctis-public/view/2024-518263-35-00